EU clinical trial 2024-518666-27-00: RE-DUAL TICLO PCI: Dual Therapy with dabigatran/ticagrelor versus Dual Therapy with dabigatran/clopidogrel in ACS patients with indication for NOAC undergoing PCI.
Sponsor: Zuyderland Medisch Centrum Stichting (Hospital/Clinic/Other health care facility). Phase: Phase III and phase IV (Integrated). Countries: Netherlands (ended).
Therapeutic area(s): Diseases [C] - Cardiovascular Diseases [C14]
Gender: Female, Male. Age: 18-64 years, 65+ years. Enrolment: 1000.
Status: Ended. End date (EU): 2025-05-07. Decision date: 2024-11-25. Results received: Yes. Last updated: 2024-11-25.

Condition(s): Acute coronary syndrome
Product: TICAGRELOR

Primary endpoint: The primary endpoint is the first bleeding event (major and clinically relevant non-major), as defined by the Bleeding Academic Research Council (BARC) score ≥2 after 12 months follow-up (12).
Endpoint(s): The secondary endpoints are efficacy endpoints of thromboembolic events (myocardial infarction, stroke, systemic embolism) and death. Other secondary endpoints are a composite endpoint of thromboembolic events or death, as well as the individual thromboembolic events and stent thrombosis.

Source: https://euclinicaltrials.eu/ctis-public/view/2024-518666-27-00